EU clinical trial 2024-513592-41-00: OM85 in the prevention of respiratory infections in elderly patients at risk
Protocol code: OM 85OLDER
Sponsor: Fondazione Policlinico Universitario Campus Bio-medico In Forma A Bbreviata Fon (Hospital/Clinic/Other health care facility). Phase: Therapeutic use (Phase IV). Countries: Italy (ongoing, recruiting).
Therapeutic area(s): Diseases [C] - Respiratory Tract Diseases [C08]
Gender: Female, Male. Age: 65+ years. Enrolment: 360.
Status: Ongoing, recruiting. Start date (EU): 2024-12-19. Decision date: 2024-09-18. Results received: No. Last updated: 2026-02-05.

Condition(s): Elderly patients with a positive history of at least two respiratory system infections in the year preceding enrollment and residents for at least 6 months in a Healthcare Residence.
Product: Same form and composition of the drug, except for the active ingredient., BRONCHO VAXOM Adulti 7 mg capsule rigide

Primary endpoint: The measured variable will be the number of respiratory tract infections (RTIs) in the two groups during the treatment period (6 months) and until the end of the observation period (further 6 months) after the start of administration of OM 85 or placebo.
Endpoint(s): rate of hospital admissions and emergency room visits in the 12 months following the start of the intervention in the OM 85 or placebo group, consumption of antibiotics in the 12 months following the start of the intervention, evaluation of the incidence of adverse events of OM-85 in elderly patients at risk by reviewing medical records

Source: https://euclinicaltrials.eu/ctis-public/view/2024-513592-41-00